EU clinical trial 2024-511994-31-00: A Phase 2, Placebo-Controlled, Randomized, Double-Blind Study of 2 Doses of Crofelemer for the Treatment of adult patients with Short Bowel Syndrome and Intestinal Failure (SBS-IF) without colon in continuity (CIC)
Protocol code: NP303-501
Sponsor: Napo Therapeutics S.p.A. (Pharmaceutical company). Phase: Therapeutic exploratory (Phase II). Countries: Germany (ongoing, recruiting), Italy (ongoing, recruiting).
Therapeutic area(s): Diseases [C] - Digestive System Diseases [C06]
Gender: Female, Male. Age: 18-64 years, 65+ years. Enrolment: 22.
Status: Ongoing, recruiting. Start date (EU): 2025-03-10. Decision date: 2024-08-26. Results received: No. Last updated: 2026-07-27.
Decision dates by country: DE: 2024-08-27, IT: 2024-08-26

Condition(s): Short Bowel Syndrome and Intestinal Failure (SBS-IF) without colon-in-continuity (CIC
Product: Crofelemer Placebo Powder for Oral Solution, Crofelemer, Crofelemer

Primary endpoint: S.1. Frequency of treatment-emergent adverse events (TEAEs), S.2. Frequency of IP interruption and/or IP discontinuation and reason, E.1. Change in weekly volume of parenteral support (PS: TPN with or without IV fluid volume) from baseline to week 24 treatment period, E.2. Change in weekly stool volume from baseline to week 24
Endpoint(s): E.3. Change from baseline in weekly volume of PS at week 2, 4, 8, 12, 16, 20 and 24, E.4. Change from baseline in weekly parenteral calories and electrolytes administered by PS at week 2, 4, 8, 12, 16, 20 and 24, E.5. Change from baseline in weekly oral fluid volume from baseline over the entire 24-week treatment period, E.6. Change in number of days/week of PS from baseline over the entire 24-week treatment period, E.7. Proportion of patients who achieve at least one day reduction in weekly PS or total weaning from PS over the entire 24-week treatment period, E.8. Change from baseline in weekly loose/watery stool volume over the entire 24-week treatment period, E.9. Change from baseline in stool consistency (according to Bristol Stool Scale) over the entire 24-week treatment period, S.3. Changes from baseline in safety laboratory parameters (in particular for liver and renal function, glucose and lipids) at week 2, 4, 8, 12, 16, 20 and 24, S.4. Changes from baseline in physical examination findings at week 2, 4, 8, 12, 16, 20 and 24

Source: https://euclinicaltrials.eu/ctis-public/view/2024-511994-31-00